EU clinical trial 2023-509455-13-00: A Phase 3, randomized, controlled, partially blind, immuno-bridging study to evaluate immunogenicity, reactogenicity, safety and the occurrence of RSV-associated respiratory tract illness after administration of a single dose of GSK’s RSVPreF3 OA investigational vaccine in adults aged 60 years and older.
Protocol code: 219815
Sponsor: GlaxoSmithKline Biologicals (Pharmaceutical company). Phase: Phase III and phase IV (Integrated). Countries: Finland (ended), Poland (ended), Spain (ended).
Therapeutic area(s): Diseases [C] - Respiratory Tract Diseases [C08]; Diseases [C] - Virus Diseases [C02]
Gender: Female, Male. Age: 18-64 years, 65+ years. Enrolment: 560.
Status: Ended. Start date (EU): 2024-08-05. End date (EU): 2025-11-27. End date: 2025-11-28. Decision date: 2024-07-22. Results received: No. Last updated: 2025-11-27.
Decision dates by country: ES: 2024-07-22, PL: 2024-07-23, FI: 2024-07-24

Condition(s): Respiratory Syncytial Virus Infections
Product: Arexvy powder and suspension for suspension for injection Respiratory Syncytial Virus (RSV) vaccine (recombinant, adjuvanted)

Primary endpoint: • RSV-A neutralization titres expressed as group GMT ratio (RSV OA group [Overseas] / RSV OA group [China]), 1 month after the RSVPreF3 OA investigational vaccine administration. • RSV-A neutralization titres expressed as group seroresponse rate (SRR) difference (RSV OA group [Overseas] - RSV OA group [China]), 1 month after the RSVPreF3 OA investigational vaccine administration., • RSV-B neutralization titres expressed as group GMT ratio (RSV OA group [Overseas] / RSV OA group [China]), 1 month after the RSVPreF3 OA investigational vaccine administration. • RSV-B neutralization titres expressed as group SRR difference (RSV OA group [Overseas] - RSV OA group [China]), 1 month after the RSVPreF3 OA investigational vaccine administration.
Endpoint(s): • RSV-A and RSV-B neutralization titres expressed as GMT, at baseline, 1 month and 6 months after the RSVPreF3 OA investigational vaccine administration. • RSV-A and RSV-B neutralization titers expressed as SRR, 1 month and 6 months after the RSVPreF3 OA investigational vaccine administration., • RSV-A and RSV-B neutralization titres expressed as group GMT ratio (RSV OA=ADJ-006 / RSV OA Vaccine group [China]), 1 month after the RSVPreF3 OA investigational vaccine administration. • RSV-A and RSV-B neutralization titres expressed as group SRR difference (RSV OA=ADJ-006 - RSV OA Vaccine group [China]), 1 month after the RSVPreF3 OA investigational vaccine administration., Occurrence of RT-PCR-confirmed RSV A and/or B-associated ARI and LRTD, according to the case definition. In study participants in China with RT-PCR-confirmed RSV A and/or B associated ARI and LRTD cases: • Duration of episodes. • Reported symptoms/signs. • ARI/LRTD severity. • Frailty status., For RSV OA group (China) and Placebo group (China): • Percentage of participants reporting each solicited administration site event with onset within 7 days after study intervention administration (i.e., the day of study intervention administration and 6 subsequent days). • Percentage of participants reporting each solicited systemic event with onset within 7 days after study intervention administration (i.e., the day of study intervention administration and 6 subsequent days)., For RSV OA group (China) and Placebo group (China): • Percentage of participants reporting unsolicited AEs within 30 days after study intervention administration (i.e., the day of study intervention administration and 29 subsequent days). • Percentage of participants reporting SAEs after study intervention administration (Day 1) up to 6 months after study intervention., For RSV OA group (China) and Placebo group (China): • Percentage of participants reporting pIMDs after study intervention administration (Day 1) up to 6 months after study intervention. • Percentage of participants reporting SAEs related to study intervention after study intervention administration (Day 1) up to study end. • Percentage of participants reporting pIMDs related to study intervention after study intervention administration (Day 1) up to study end., For RSV OA group (China) and Placebo group (China): • Percentage of participants reporting any fatal SAEs after study intervention administration (Day 1) up to study end., For RSV OA group (Overseas): • Percentage of participants reporting SAEs after study intervention administration (Day 1) up to study end (Month 6). • Percentage of participants reporting pIMDs after study intervention administration (Day 1) up to study end (Month 6). • Percentage of participants reporting SAEs related to study intervention after study intervention administration (Day 1) up to study end (Month 6)., For RSV OA group (Overseas): • Percentage of participants reporting pIMDs related to study intervention after study intervention administration (Day 1) up to study end (Month 6). • Percentage of participants reporting any fatal SAEs after study intervention administration (Day 1) up to study end (Month 6).

Source: https://euclinicaltrials.eu/ctis-public/view/2023-509455-13-00